EU clinical trial 2025-520725-20-00: Selective decontamination of the digestive tract in preventing surgical site infections in elective colorectal surgery: a randomised controlled trial (SELDDEC Trial)
Sponsor: University Hospital Limerick (Hospital/Clinic/Other health care facility). Phase: Therapeutic exploratory (Phase II). Countries: Ireland (authorised, recruitment pending).
Therapeutic area(s): Diseases [C] - Bacterial Infections and Mycoses [C01]
Gender: Female, Male. Age: 18-64 years, 65+ years. Enrolment: 322.
Status: Authorised, recruitment pending. Decision date: 2025-01-30. Results received: No. Last updated: 2025-05-07.

Condition(s): Surgical site infection
Product: Erythromycin Tablets BP 250mg, Neomycin 500mg Tablets

Primary endpoint: Incidence of surgical site infection
Endpoint(s): Infectious complications other than surgical site infections, length of hospital stay, postoperative complications as per Clavien Dindo Classification, anastomotic leakage and mortality

Source: https://euclinicaltrials.eu/ctis-public/view/2025-520725-20-00